EU clinical trial 2023-506938-68-00: Randomised, crossover bioequivalence clinical trial of donepezil 5 mg capsules vs donepezil 5 mg film-coated tablets, after a single oral dose administration to healthy volunteers under fasting conditions
Protocol code: UECHUP-DON/23-5
Sponsor: Laboratorios Alter S.A. (Pharmaceutical company). Phase: Human Pharmacology (Phase I)- Bioequivalence Study. Countries: Spain (ended).
Therapeutic area(s): Diseases [C] - Nervous System Diseases [C10]
Gender: Female, Male. Age: 18-64 years. Enrolment: 30.
Status: Ended. Start date (EU): 2024-05-03. End date (EU): 2024-06-14. Decision date: 2024-03-13. Results received: No. Last updated: 2024-05-14.
Decision dates by country: ES: 2024-04-25

Condition(s): Alzheimer's disease

Source: https://euclinicaltrials.eu/ctis-public/view/2023-506938-68-00